EU clinical trial 2024-511916-25-00: Phase I, Open-label, Dose-escalating, Clinical and Pharmacokinetic Study of PM14 Administered Intravenously to Patients with Advanced Solid Tumors
Protocol code: PM14-A-001-17
Sponsor: Pharma Mar S.A. (Pharmaceutical company). Phase: Phase I and Phase II (Integrated)- First administration to humans. Countries: Spain (ended), France (ended).
Therapeutic area(s): Diseases [C] - Neoplasms [C04]
Gender: Female, Male. Age: 18-64 years, 65+ years. Enrolment: 115.
Status: Ended. Start date (EU): 2017-09-04. End date (EU): 2025-08-21. End date: 2025-08-22. Decision date: 2024-04-26. Results received: No. Last updated: 2025-02-24.
Decision dates by country: FR: 2024-05-02, ES: 2024-04-26

Condition(s): Advanced Solid Tumors

Source: https://euclinicaltrials.eu/ctis-public/view/2024-511916-25-00